EU clinical trial 2024-515999-13-00: LOW-DOSE DOBUTAMINE INFUSION AND SINGLE-DOSE TOCILIZUMAB IN ACUTE MYOCARDIAL INFARCTION PATIENTS WITH HIGH RISK OF CARDIOGENIC SHOCK DEVELOPMENT (DOBERMANN) - A 2X2 MULTIFACTORIAL, DOUBLE-BLINDED, RANDOMIZED, PLACEBO-CONTROLLED TRIAL
Protocol code: RH-CARD-Pharma001
Sponsor: Rigshospitalet (Hospital/Clinic/Other health care facility). Phase: Therapeutic use (Phase IV). Countries: Denmark (ended).
Therapeutic area(s): Diseases [C] - Cardiovascular Diseases [C14]
Gender: Female, Male. Age: 18-64 years, 65+ years. Enrolment: 100.
Status: Ended. Start date (EU): 2022-03-13. End date (EU): 2025-09-30. Decision date: 2024-09-25. Results received: No. Last updated: 2025-03-25.

Condition(s): Acute Myocardial Infarction with increased risk of Cardiogenic Shock
Product: Dobutrex, koncentrat til infusionsvæske, opløsning, Isoton (0,9%) NaCl, RoActemra 20 mg/mL concentrate for solution for infusion

Primary endpoint: NTproBNP in blood samples drawn from hospital admission to 48 hours after admission.
Endpoint(s): Infarct size measured by cMRi during index admission and after 3 months, Biomarkers reflecting neurohormonal activation, endothelial function/damage, inflammation (pro- and anti-inflammatory processes – including IL-6 and C-reactive peptide (CRP)), connec-tive tissue damage, organ dysfunction, and other relevant processes, 2D echocardiographic measurements of hemodynamics (VTI) and left ventricular function including strain measurements according to protocol, SOFA score (PaO2, FiO2, on medical ventilation, Platelets, GCS, Bilirubin, mean arterial pressure OR administration of vasoactive agents required, Creatinine, COVID-19 status), Development of in-hospital CS and/or in-hospital cardiac arrest and/or transfer to the ICU during index admission, Long-term all-cause mortality, PCI operator's post-procedure clinical assessment of the patient (survives to discharge 'yes/no'), Development of non-cardiac arrest arrythmia (sustained ventricular tachycardia, atrial fibrillation with a frequency above 120 for more than 30 minutes) during index admission (safety), Re-admission (all cause and cardiovascular) during the first year after index hospitalization, Re-admission with heart failure and re-infarction during the first year after index hospitalization, Quality of Life and mental and cognitive health at baseline and after three months

Source: https://euclinicaltrials.eu/ctis-public/view/2024-515999-13-00